EU clinical trial 2024-513708-33-00: A Phase 1 Open-Label, Safety, Pharmacokinetic and Preliminary Efficacy Study of STRO-002, an Anti-Folate Receptor alpha (FolRα) Antibody Drug Conjugate (ADC), in Combination with Bevacizumab in Patients with Advanced Epithelial Ovarian Cancer (Including Fallopian Tube or Primary Peritoneal Cancers)
Protocol code: STRO-002-GM2
Sponsor: Sutro Biopharma Inc. (Pharmaceutical company). Phase: Human Pharmacology (Phase I)- First administration to humans. Countries: France (ended), Italy (ended), Spain (ended).
Therapeutic area(s): Diseases [C] - Female Urogenital Diseases and Pregnancy Complications [C13]
Gender: Female. Age: 18-64 years, 65+ years. Enrolment: 20.
Status: Ended. Start date (EU): 2022-11-23. End date (EU): 2025-07-16. End date: 2025-07-17. Decision date: 2024-11-04. Results received: No. Last updated: 2024-11-26.
Decision dates by country: FR: 2024-11-08, IT: 2024-11-26, ES: 2024-11-04

Condition(s): Advanced Epithelial Ovarian Cancer (including Fallopian Tube or Primary Peritoneal cancers)

Source: https://euclinicaltrials.eu/ctis-public/view/2024-513708-33-00